EU clinical trial 2025-521400-21-00: The pivotal bioequivalence study comparing the test product to the reference product, which belongs to the group of medicines used in treatment of schizophrenia in adult patients.
Protocol code: 1028/25
Sponsor: Adamed Pharma S.A. (Pharmaceutical company). Phase: Human Pharmacology (Phase I)- Bioequivalence Study. Countries: Czechia (ended).
Therapeutic area(s): Psychiatry and Psychology [F] - Mental Disorders [F03]
Gender: Female, Male. Age: 18-64 years. Enrolment: 54.
Status: Ended. Start date (EU): 2025-05-15. End date (EU): 2025-09-25. Decision date: 2025-05-14. Results received: No. Last updated: 2025-12-01.

Condition(s): Not applicable (submitted trial is a BE study in healthy subjects).

Source: https://euclinicaltrials.eu/ctis-public/view/2025-521400-21-00